EU clinical trial 2024-520369-30-00: A Study of EOS006215 in Adult Participants with Advanced Solid Tumors
Protocol code: TRM-010
Sponsor: iTeos Belgium (Pharmaceutical company). Phase: Human Pharmacology (Phase I)- First administration to humans. Countries: Belgium (ended).
Therapeutic area(s): Phenomena and Processes [G] - Cell Physiological Phenomena [G04]
Gender: Female, Male. Age: 18-64 years, 65+ years. Enrolment: 47.
Status: Ended. End date (EU): 2025-07-09. Decision date: 2025-04-01. Results received: No. Last updated: 2025-04-01.

Condition(s): Solid Tumors

Source: https://euclinicaltrials.eu/ctis-public/view/2024-520369-30-00